EU clinical trial 2023-505135-12-00: A Phase 1 Study to Evaluate the Safety, Tolerability, and Immunogenicity of a pDNA Vaccine Candidate Against COVID-19 in Healthy Adults
Protocol code: IAU-1-001-2021
Sponsor: Imam Abdulrahman Bin Faisal University (Educational Institution). Phase: Human Pharmacology (Phase I)- First administration to humans. Countries: Belgium (not authorised).
Therapeutic area(s): Diseases [C] - Virus Diseases [C02]
Gender: Female, Male. Age: 18-64 years. Enrolment: 60.
Status: Not authorised. Decision date: 2023-10-13. Results received: No. Last updated: 2023-10-13.

Condition(s): Covid-19 Prophylaxis

Source: https://euclinicaltrials.eu/ctis-public/view/2023-505135-12-00